EU clinical trial 2024-517389-40-00: Efficacy and safety of obinutuzumab versus rituximab in combination with chemotherapy for adult patients with newly diagnosed CD20-positive acute lymphoblastic leukemia
Protocol code: PALG ALL7 “OVERALL"
Sponsor: Narodowy Instytut Onkologii Im. Marii Sklodowskiej-Curie Panstwowy Instytut Badawczy (Hospital/Clinic/Other health care facility). Phase: Therapeutic exploratory (Phase II). Countries: Poland (ended).
Therapeutic area(s): Diseases [C] - Hemic and Lymphatic Diseases [C15]; Diseases [C] - Neoplasms [C04]
Gender: Female, Male. Age: 18-64 years, 65+ years. Enrolment: 124.
Status: Ended. Start date (EU): 2021-10-06. End date (EU): 2026-04-21. Decision date: 2024-10-07. Results received: No. Last updated: 2025-11-04.

Condition(s): acute lymphoblastic leukemia
Product: OBINUTUZUMAB, RITUXIMAB

Primary endpoint: The proportion of patients achieving complete remission (CR) with MRD level <0.1% of bone marrow cells after one course of induction treatment
Endpoint(s): The proportion of patients achieving CR with MRD level <0.01% of bone marrow cells after consolidation., CR rate after Induction I., Overall CR rate in 24 month follow-up., Probability of overall survival (OS) in 24 month follow-up, Probability of relapse-free survival (RFS) in 24 month follow-up, Probability of event-free survival (EFS) in 24 month follow-up, Cumulative incidence of relapse in 24 month follow-up, Rate of adverse events in 24 month follow-up.

Source: https://euclinicaltrials.eu/ctis-public/view/2024-517389-40-00